EU clinical trial 2023-505977-34-00: Phase I/II randomized clinical trial of allogeneic adipose tissue-derived mesenchymal stromal cells systemic infusion in severe systemic sclerosis; MSC-AT-SSc
Protocol code: APHP211026
Sponsor: Assistance Publique Hopitaux De Paris (Hospital/Clinic/Other health care facility). Phase: Therapeutic exploratory (Phase II). Countries: France (ongoing, recruiting).
Therapeutic area(s): Diseases [C] - Immune System Diseases [C20]
Gender: Female, Male. Age: 18-64 years, 65+ years. Enrolment: 18.
Status: Ongoing, recruiting. Start date (EU): 2025-01-08. Decision date: 2024-11-21. Results received: No. Last updated: 2026-04-03.

Condition(s): Systemic sclerosis
Product: MSCAT-THAC Placebo, Allogeneic Mesenchymal stromal cells derived from adipose tissue thawed and cultured

Primary endpoint: The rate of treatment-related Severe Adverse Events (SAE) defined as Adverse Events (AE) of grade equal or above 3 using the NCI Common Terminology Criteria for Adverse Events (CTCAE) v5.0 classification, at one month after each infusion (M1, M4).
Endpoint(s): - Rate of treatment-related SAE defined as AE of grade equal or above 3 CTCAE v5.0 at time and within the first 24 hours of infusion and during all follow-up at: M0, M3, M6, M9 and M12, - Main efficacy endpoint: modified Rodnan Skin Score (mRSS) difference between M0 and M12., - Other efficacy disease related endpoints : o mRSS at M3, M6 and M9 o WHO performance status (PS) and Health-Related Quality of Life (HRQoL) questionnaires : Scleroderma-Health Assessment Questionnaire (SHAQ), the Short Form (36) health survey (SF-36v2) and EQ-5D-5L at M0, M3, M6, and M12; o Forced Vital Capacity (FVC) and Diffusing capacity of Lung for carbon monoxide (DLCO) at M0, M6 and M12., - PFS at M12, with progression defined as any of the following: decreased in FVC > 10% or in DLCO > 15%; decrease in LVEF% > 15%; decrease in weight > 15%; decrease in creatinine clearance > 30%; increased mRSS > 25% ; and/or increase in SHAQ> 0.5., - GRCS values at M3, M6, and M12., - CRISS values for early SSc patients at M3, M6, and M12., - Overall survival at M12, - Myeloid and lymphocyte sub-populations in all included patients at M0, M1, M3, M4, M6., - Alloimmunization in all included patients through the detection and identification of donor-specific anti-HLA antibodies at M0, M3 and M6, - Extra-Cost per QALY (quality-adjusted Life Year) gained by unique and repeated IV infusion of allogeneic MSC(AT) in severe SSc after 12 months., - Extra-Cost per SAE of grade above or equal to 3 CTCAE avoided by unique and repeated IV infusion of allogeneic MSC(AT) in severe SSc after 12 months.

Source: https://euclinicaltrials.eu/ctis-public/view/2023-505977-34-00